EU clinical trial 2023-507904-30-00: A Phase I, Open-label, Parallel Group Study to Investigate Olaparib Safety and Tolerability, Efficacy and Pharmacokinetics in Paediatric Patients with Solid Tumours
Protocol code: D0816C00025
Sponsor: AstraZeneca AB (Pharmaceutical company). Phase: Human Pharmacology (Phase I)- Other. Countries: Italy (ended), Denmark (ended), Hungary (ended), France (ended), Spain (ended).
Therapeutic area(s): Diseases [C] - Neoplasms [C04]
Gender: Female, Male. Age: 0-17 years. Enrolment: 25.
Status: Ended. Start date (EU): 2020-01-27. End date (EU): 2025-02-04. End date: 2025-02-05. Decision date: 2024-10-08. Results received: Yes. Last updated: 2025-05-26.
Decision dates by country: DK: 2024-10-08, FR: 2024-10-29, IT: 2024-11-20, ES: 2024-10-10, HU: 2024-10-09

Condition(s): solid tumors
Product: Lynparza 100 mg film-coated tablets, AZD2281, AZD2281, AZD2281

Primary endpoint: DLTs, RP2D, AEs/SAEs/deaths, discontinuation rate of olaparib treatment due to AEs throughout the study, clinical chemistry/haematology parameters, vital signs
Endpoint(s): PK parameters: CLss/F, Css,max, Css, min, tss,max, AUCss, dose normalised AUCss, AUC(0-8), AUC0-t, and dose normalised Css,max ORR, DCR and DoR as defined by Investigator-assessed RECIST v1.1, INRC, or RANO

Source: https://euclinicaltrials.eu/ctis-public/view/2023-507904-30-00